EU clinical trial 2024-513041-37-00: CeRebrUm and CardIac protection with ALlopurinol in Neonates with Critical Congenital Heart Disease requiring Cardiac Surgery with Cardiopulmonary Bypass
Protocol code: 18-791
Sponsor: Universitair Medisch Centrum Utrecht (Hospital/Clinic/Other health care facility). Phase: Therapeutic confirmatory (Phase III). Countries: Netherlands (authorised, recruiting).
Therapeutic area(s): Diseases [C] - Congenital, Hereditary, and Neonatal Diseases and Abnormalities [C16]
Gender: Female, Male. Age: 0-17 years. Enrolment: 236.
Status: Authorised, recruiting. Start date (EU): 2020-02-14. Decision date: 2024-07-31. Results received: No. Last updated: 2026-04-09.

Condition(s): Brain injury in neonates with critical congenital heart disease requiring cardiac surgery with cardiopulmonary bypass.
Product: Placebo Mannitol 100mg pfi, ACEPURIN, poeder voor infusievloeistof 1g/100 ml

Primary endpoint: Primary outcome is a composite endpoint of relevant (moderate / severe) parenchymatous brain injury on postoperative MRI or too instable for postoperative MRI or mortality.
Endpoint(s): Brain injury severity score and volume of hypoxic-ischemic brain injury (pre- and postoperative MRI), Brain function: background pattern and seizure activity (postnatal and perioperative amplitude integrated electroencephalogram)., Cerebral oxygenation (postnatal and perioperative near-infrared spectroscopy)., Cardiac function (pre- and postoperative echocardiography)., Neurodevelopmental outcome (general movements at 3 months and Bayley scales of infant development and executive functioning testing at 24 months)., Quality of life (TNO-TAPQOL at 24 months), Cost effectiveness of allopurinol (questionnaires during hospital stay at 3 and 24 months), Pharmacokinetics of allopurinol (substudy: postnatally, perioperatively)

Source: https://euclinicaltrials.eu/ctis-public/view/2024-513041-37-00